EU clinical trial 2024-518043-38-00: MOOD - MethOxyflurane analgesia in vasoOcclusive crises of sickle cell Disease
Protocol code: APHP180608
Sponsor: Assistance Publique Hopitaux De Paris (Hospital/Clinic/Other health care facility). Phase: Therapeutic confirmatory (Phase III). Countries: France (not authorised).
Therapeutic area(s): Diseases [C] - Congenital, Hereditary, and Neonatal Diseases and Abnormalities [C16]; Diseases [C] - Pathological Conditions, Signs and Symptoms [C23]
Gender: Female, Male. Age: 18-64 years, 65+ years. Enrolment: 198.
Status: Not authorised. Decision date: 2026-05-29. Results received: No. Last updated: 2026-05-29.

Condition(s): Sickle cell disease
Product: MORPHINE SULFATE, PENTHROX 99,9%, liquide pour inhalation par vapeur de 3 mL, MORPHINE SULFATE, OXYCODONE HYDROCHLORIDE

Primary endpoint: The mean pain intensity measured by VAS (Visual Analogic Scale) every 10 minutes during the first hour after admission in the emergency department
Endpoint(s): Patient's satisfaction measured at the 60th minute by Likert scale ranging from 1 to 10., Global ED nurse's satisfaction measured within the first 8h by Likert scale ranging from 1 to 10., Total amount (in milligram) of intravenous morphine and analgesics (Nefopam, Paracetamol, and Tramadol) administered until emergency discharge, Duration of stay (in days) from arrival to emergency department to the end of hospitalization., Calculation of the cost of Penthrox® (number of bottles used), Calculation of the cost of oral administration of opioid analgesics (number of pills used), such as Oral Oxycodone Hydrochloride (OxynormORO®) or Morphine Sulfate (Actiskenan® ), Incidence of renal and liver events based on the difference of kidney and liver function between the time of emergency admission and the third to seventh day of hospitalization (if several values are available, the worse value is retained), Incidence of acute chest syndrome during hospitalization, Incidence of neurologic events such as ischemic stroke

Source: https://euclinicaltrials.eu/ctis-public/view/2024-518043-38-00